EU clinical trial 2022-500594-13-00: A Phase IIa, Randomized, Double-blind, Placebo-controlled Study to Evaluate Safety, Tolerability, and Pharmacodynamics of AZD4831 in Participants with Non-cirrhotic Non-alcoholic Steatohepatitis (NASH) with Fibrosis
Protocol code: D6581C00001
Sponsor: Astrazeneca AB (Pharmaceutical company). Phase: Therapeutic exploratory (Phase II). Countries: Sweden (ended), Spain (ended), Denmark (ended), Italy (ended), Norway (ended), Portugal (ended).
Therapeutic area(s): Diseases [C] - Nutritional and Metabolic Diseases [C18]; Phenomena and Processes [G] - Metabolism [G03]; Diseases [C] - Pathological Conditions, Signs and Symptoms [C23]
Gender: Female, Male. Age: 18-64 years, 65+ years. Enrolment: 48.
Status: Ended. Start date (EU): 2022-12-14. End date (EU): 2024-04-04. End date: 2024-04-04. Decision date: 2022-10-27. Results received: Yes. Last updated: 2023-08-01.
Decision dates by country: ES: 2022-10-31, NO: 2022-12-19, DK: 2022-10-27, IT: 2022-11-03, SE: 2022-11-01, PT: 2023-02-17

Condition(s): "Non-Alcoholic Steatohepatatis (NASH) is the progressive form of Non-Alcoholic Fatty Liver Disease (NAFLD)with a prevalence of approximately 2% to 3% of the general population. Non-alcoholic steatohepatitis can lead to cirrhosis and its complications, hepatocellular carcinoma, and end stage liver disease. Non-alcoholic steatohepatitis is defined histologically as a multicomponent condition composed of hepatic steatosis, inflammation, and hepatocyte ballooning in varying proportions. NASH differs from steatosis alone by the presence of hepatic cell inflammation and injury in response to lipotoxic intermediates that are accumulated and metabolized in the steatotic liver. NASH is closely associated with metabolic risk factors including obesity, T2DM, and dyslipidemia. Pathophysiologically, NASH is frequently associated with a hyperinsulinemic or insulin resistant state, leading to adipose tissue dysfunction and increased hepatic de novo lipogenesis."
Product: AZD4831 Placebo, AZD4831

Primary endpoint: Change from baseline and over placebo to Week 12: ALT
Endpoint(s): Change from baseline and over placebo to Week 12: ProC3, Plasma concentration of AZD4831 will be summarized by timepoints and dose level. If PK data permit, a population PK model may be developed and potentially coupled with separate PD models; the derived PK parameters and the modelling will be provided in a separate PK and population PK/PD report.

Source: https://euclinicaltrials.eu/ctis-public/view/2022-500594-13-00